EU clinical trial 2024-511641-18-00: Phase II multicenter single arm study to evaluate the efficacy and safety of ibrutinib in combination to rituximab-CHOP followed by ibrutinib maintenance in untreated patients with Activated-B-Cell (ABC)-DLBCL at intermediate-high and high risk (IPI ≥2)
Protocol code: FIL_RI-CHOP
Sponsor: Fondazione Italiana Linfomi Ets (Patient organisation/association). Phase: Therapeutic exploratory (Phase II). Countries: Italy (ongoing, recruitment ended).
Therapeutic area(s): Diseases [C] - Hemic and Lymphatic Diseases [C15]
Gender: Female, Male. Age: 18-64 years. Enrolment: 75.
Status: Ongoing, recruitment ended. Start date (EU): 2019-08-01. Decision date: 2024-12-02. Results received: No. Last updated: 2026-07-20.

Condition(s): Diffuse Large B-cell Lymphoma ABC
Product: RITUXIMAB, DOXORUBICIN, CYCLOPHOSPHAMIDE, VINCRISTINE, RITUXIMAB, PREDNISONE, IBRUTINIB

Primary endpoint: Progression-free survival (PFS) of the high/high-intermediate risk patients from date of enrolment
Endpoint(s): Event Free Survival (EFS) and Overall survival (OS), Rate of complete response (CRR) and of overall response (ORR), Duration of response (DOR), Rate of complete response (CRR) before and after maintenance, Rate of conversion in CR with Ibrutinib maintenance for patients in PR after the induction with RI-CHOP21, Toxicity: all grade of toxicity and severe, life- threatening, fatal (grade 3, 4 and 5) and/or serious adverse events will be defined according to “Common Terminology Criteria for Adverse Events” (CTCAE)

Source: https://euclinicaltrials.eu/ctis-public/view/2024-511641-18-00